EU clinical trial 2023-503865-48-00: An Open-Label, Phase 2b, Global Multicenter Cohort Trial to Assess the Safety and Efficacy of Zipalertinib in Patients with Locally Advanced or Metastatic Non-Small Cell Lung Cancer with Exon 20 Insertion and Uncommon/Single or Compound Epidermal Growth Factor Receptor Mutations
Protocol code: TAS6417-201
Sponsor: Taiho Oncology Inc. (Pharmaceutical company). Phase: Therapeutic exploratory (Phase II). Countries: Italy (ongoing, recruiting), Spain (ongoing, recruiting), Germany (ongoing, recruiting), France (ongoing, recruiting).
Therapeutic area(s): Diseases [C] - Neoplasms [C04]
Gender: Female, Male. Age: 18-64 years, 65+ years. Enrolment: 117.
Status: Ongoing, recruiting. Start date (EU): 2024-02-16. Decision date: 2023-11-06. Results received: No. Last updated: 2026-06-12.
Decision dates by country: IT: 2023-11-07, FR: 2023-11-10, ES: 2023-11-06, DE: 2023-11-07

Condition(s): Locally Advanced or Metastatic Non-Small Cell Lung Cancer
Product: Digoxin, Zipalertinib, Dextromethorphan, Midazolam, Zipalertinib, Rosuvastatin

Primary endpoint: ORR, defined as the proportion of patients experiencing the best overall confirmed response of CR or PR, RECIST 1.1.
Endpoint(s): Adverse events (AE) graded according to NCI-Common Terminology Criteria of Adverse Events Version 5.0 (CTCAE v5.0), clinical laboratory tests, vital signs, ECGs, and echo/MUGA, Antitumor activity will be evaluated per RECIST 1.1: -Duration of response defined the first objective response to progression or to death due to any cause, whichever occurs first - Progression-free survival defined the first treatment dose until the disease progression per death, whichever occurs first, Overall survival (OS), measured from the date of first dose of study treatment until the date of death from any cause, Intracranial (i) ORR (iORR), iDoR, and iDCR, as determined by RANO-BM criteria, Observed minimum concentration (Cmin) of zipalertinib in plasma

Source: https://euclinicaltrials.eu/ctis-public/view/2023-503865-48-00